EU clinical trial 2023-503983-17-00: Nitroglycerin for Esophageal Food Impaction: A Multicenter, Double-blind, Randomized, Placebo-Controlled, Phase 2 Clinical trial
Protocol code: MK2021
Sponsor: Region Hovedstaden (Hospital/Clinic/Other health care facility). Phase: Therapeutic exploratory (Phase II). Countries: Denmark (ongoing, recruiting).
Therapeutic area(s): Diseases [C] - Otorhinolaryngologic Diseases [C09]; Diseases [C] - Digestive System Diseases [C06]
Gender: Female, Male. Age: 18-64 years, 65+ years. Enrolment: 88.
Status: Ongoing, recruiting. Start date (EU): 2025-06-12. Decision date: 2023-08-28. Results received: No. Last updated: 2026-02-03.

Condition(s): Esophageal Food Impaction
Product: Nitroglycerin "DAK", sublinguale resoribletter, Placebo 6 mm convex. White, round and normal convex tablets. Size 6 mm. The placebo is developed at the Capital Region Pharmacy in Denmark. The formulation is identical with a marketed SAD tablet but without active ingredient. Therefore no specific documentation for the pharmaceutical development is made., Placebo

Primary endpoint: • The number of patients with resolution of EFI without the need of endoscopic removal when treated with nitroglycerin (NGT) compared to the number of patients with resolution of EFI when treated with placebo.

Source: https://euclinicaltrials.eu/ctis-public/view/2023-503983-17-00